EU clinical trial 2023-506352-24-00: BMS CV027-031, A Randomized, Double-blind, Placebo-controlled Clinical Study to Evaluate Mavacamten in Adults with Symptomatic Nonobstructive Hypertrophic Cardiomyopathy
Protocol code: CV027-031
Sponsor: Myokardia Inc. (Pharmaceutical company). Phase: Therapeutic confirmatory (Phase III). Countries: Czechia (ended), Belgium (ended), Norway (ended), Spain (ended), Poland (ended), Hungary (ended), Netherlands (ended), Germany (ended), Portugal (ended), France (ended), Austria (ended), Denmark (ended), Italy (ended).
Therapeutic area(s): Diseases [C] - Cardiovascular Diseases [C14]
Gender: Female, Male. Age: 18-64 years, 65+ years. Enrolment: 282.
Status: Ended. Start date (EU): 2023-04-13. End date (EU): 2025-10-20. End date: 2025-10-21. Decision date: 2024-05-06. Results received: Yes. Last updated: 2025-10-10.
Decision dates by country: DK: 2024-05-06, NO: 2024-05-08, HU: 2024-05-08, DE: 2024-05-08, PT: 2024-05-06, AT: 2024-05-10, NL: 2024-05-06, IT: 2024-06-17, CZ: 2024-05-07, ES: 2024-05-13, BE: 2024-05-07, FR: 2024-05-21, PL: 2024-05-07

Condition(s): Non-obstructive Hypertrophic Cardiomyopathy
Product: Mavacamten, MYK-461 Capsules, Placebo is a solid oral dosage form in size 2 gelatin capsules each containing 120 mg of an excipient blend. It is intended as a placebo to match MYK-461 Capsules of all active strengths., Mavacamten, Mavacamten, Mavacamten, Mavacamten

Primary endpoint: Change from baseline in KCCQ CSS at Week 48, Change from baseline in pVO2 at Week 48
Endpoint(s): Change from baseline in VE/VCO2 slope to Week 48, Proportion of participants with at least 1 class of NYHA improvement from baseline to Week 48, (3.-4.) 3. Change from baseline in NT-pro BNP to Week 48 4. Change from baseline in cTn-T to Week 48, (5.-6.) 5. Change from baseline in HCMSQ-SoB domain to Week 48 6. Time to First MACE-Plus events defined as any CV death, non-fatal myocardial infarction, non-fatal stroke, hospitalization for heart failure, hospitalization for arrhythmias or appropriate ICD therapy

Source: https://euclinicaltrials.eu/ctis-public/view/2023-506352-24-00